EU clinical trial 2024-512621-88-00: Phase 2, proof-of-concept, randomized, double-blinded, placebo-controlled, multicenter study to assess efficacy and safety of reparixin as add-on therapy to standard of care in adult patients with Acute Respiratory Distress Syndrome (RESPIRATIO)
Protocol code: REP0122
Sponsor: Dompe' Farmaceutici S.p.A. (Pharmaceutical company). Phase: Therapeutic exploratory (Phase II). Countries: Italy (ended), Germany (ended).
Therapeutic area(s): Diseases [C] - Respiratory Tract Diseases [C08]
Gender: Female, Male. Age: 18-64 years, 65+ years. Enrolment: 15.
Status: Ended. Start date (EU): 2022-12-06. End date (EU): 2025-04-14. End date: 2025-04-18. Decision date: 2024-07-24. Results received: Yes. Last updated: 2025-01-31.
Decision dates by country: DE: 2024-09-26, IT: 2024-07-24

Condition(s): Acute Respiratory Distress Syndrome
Product: Reparixin, Placebo - Tablet for oral use

Primary endpoint: Change in oxygenation index (OI) from baseline to day 7 of treatment. The OI is defined as: % mean airway pressure x FIO2/PaO2, Ventilator free days (VFD) at day 28
Endpoint(s): Change in OI from baseline to day 4, Acute lung injury score [composite of PaO2/FIO2 ratio, PEEP, lung compliance (plateau airway pressure minus PEEP/TV) and extent of pulmonary infiltrates] at 2, 3, 7, 14 days (if still intubated), SOFA scores at 2, 3, 7, 14 days (if still intubated), Ventilatory ratio (product of minute ventilation and PaCO2) at 2, 3, 7, 14 days (if still intubated), Incidence of ECMO at day 14, Use of vasoactive medications at day 14, CXR assessment of pulmonary edema by "radiographic assessment of lung edema" (RALE) score at 2, 3, 7, 14 days, Percentage of patients achieving pressure support ventilation equal to 5 cm H20 with PEEP equal to 5 cm H20 for 2 hours (measure of weaning) by day 28 and hospital discharge, ICU-free days by day 28 and hospital discharge, Hospital-free days by day 28 and hospital discharge, Incidence of tracheostomies by day 28 and hospital discharge, Incidence of LTAC facility by day 28 and hospital discharge, All-cause mortality by day 28, Hospital discharge by day 28, All-cause mortality by day 60, Change from baseline to day 3, 7 and 14 in plasma levels of Il-6, IL-8, PAI-1, Plasma TNFr-1, ICAM-1 RAGE

Source: https://euclinicaltrials.eu/ctis-public/view/2024-512621-88-00